EU clinical trial 2022-501515-14-00: A Phase 3, Two-stage, Randomized, Multi-center, Controlled, Open-label Study Comparing Iberdomide Maintenance to Lenalidomide Maintenance Therapy after Autologous Stem Cell Transplantation (ASCT) in Participants with Newly Diagnosed Multiple Myeloma (NDMM) (EXCALIBER-Maintenance)
Protocol code: IM048-022
Sponsor: Celgene Corp. (Pharmaceutical company). Phase: Therapeutic confirmatory (Phase III). Countries: Portugal (ongoing, recruiting), Spain (ongoing, recruiting), Denmark (ongoing, recruiting), Austria (ongoing, recruiting), Italy (ongoing, recruiting), Belgium (ongoing, recruiting), Poland (ongoing, recruiting), Finland (ongoing, recruiting), Germany (ongoing, recruiting), Greece (ongoing, recruiting), France (ongoing, recruiting), Sweden (ongoing, recruiting), Romania (ongoing, recruiting), Netherlands (ongoing, recruiting), Czechia (ongoing, recruiting), Hungary (ongoing, recruiting).
Therapeutic area(s): Diseases [C] - Neoplasms [C04]
Gender: Female, Male. Age: 18-64 years, 65+ years. Enrolment: 464.
Status: Ongoing, recruiting. Start date (EU): 2023-09-29. Decision date: 2023-08-14. Results received: No. Last updated: 2026-06-10.
Decision dates by country: FR: 2023-08-16, BE: 2024-01-22, DK: 2023-08-15, IT: 2023-08-16, AT: 2023-08-14, PT: 2023-08-16, FI: 2023-08-14, SE: 2023-08-21, DE: 2023-08-17, ES: 2023-08-17, RO: 2023-08-21, HU: 2023-08-17, NL: 2023-08-14, GR: 2023-08-17, CZ: 2023-08-17, PL: 2023-08-21

Condition(s): Newly Diagnosed Multiple Myeloma (NDMM)
Product: Aspirin 75mg gastro-resistant tablets, Iberdomide, Xarelto 2.5 mg film-coated tablets, Clexane 10,000 IU (100mg)/1ml Solution for Injection in pre-filled syringes, Revlimid 5 mg hard capsules, Iberdomide, Revlimid 15 mg hard capsules, Warfarin Teva 0.5mg Tablets, Iberdomide, Eliquis 2.5 mg film-coated tablets, Iberdomide, Revlimid 10 mg hard capsules, Iberdomide

Primary endpoint: PFS, defined as the time from randomization to the first documentation of progressive disease according to International Myeloma Working Group (IMWG) Uniform Response Criteria for MM or death due to any cause, whichever occurs first
Endpoint(s): Achieving MRD negativity (at a threshold of 10–5 by next-generation flow) in participants who are in a response of CR or better at 12 (±3) months post start of maintenance treatmen, OS, defined as the time from randomization to deathdue to any cause, Recommended iberdomide dose for Stage 2, PK of iberdomide, Safety (type, frequency, seriousness, and severity of AEs), and relationship of AEs to study treatment, PFS2 is defined as the time from randomization to progression on the next anti-myeloma treatment or death due to any cause, whichever occurs first, Achieving MRD negativity (at a threshold of 10-5 by next-generation flow) in participants with a response of CR or better at any time after the date of randomization, Conversion from MRD-positive to MRD-negative in participants with a response of CR or better (at a threshold of 10-5 by next-generation flow), Achievement of a response of CR or better and maintaining MRD-negative status (at a threshold of 10-5 by next-generation flow) in 2 bone marrow aspirate assessments that are a minimum of 1 year apart, without any examination showing MRD positive status in between assessments, TTP, defined as the time from randomization to the first documentation of disease progression according to IMWG Uniform Response Criteria for MM, TTNT is defined as the time from randomization to the start of the participant receiving any anti myeloma treatment other than study treatment, Best response achieved in participants who enroll with a suboptimal response (PR or VGPR), or CR or better prior to PD, Subscale and total scores in patient-reported HRQoL outcomes and multiple myeloma-related symptoms as measured by the European Organization for Research and Treatment of Cancer [EORTC] QLQ-C30, EORTC QLQ-MY20

Source: https://euclinicaltrials.eu/ctis-public/view/2022-501515-14-00